EU clinical trial 2025-522529-36-00: Postoperative recovery with the addition of long-acting NK1- and 5-HT3 receptor antagonists as prophylaxis for post-operative nausea and vomiting. A prospective, double-blind, randomized trial in laparoscopic surgery.
Protocol code: Palpitant-study
Sponsor: Region Vaesternorrland, Umea University (Hospital/Clinic/Other health care facility, Educational Institution). Phase: Therapeutic confirmatory (Phase III). Countries: Sweden (authorised, recruitment pending).
Therapeutic area(s): Analytical, Diagnostic and Therapeutic Techniques and Equipment [E] - Anesthesia and Analgesia [E03]
Gender: Female, Male. Age: 18-64 years, 65+ years. Enrolment: 220.
Status: Authorised, recruitment pending. Decision date: 2025-12-15. Results received: No. Last updated: 2025-12-15.

Condition(s): Post-operative nausea and vomiting (PONV)
Product: PALONOSETRON, FOSAPREPITANT, SODIUM CHLORIDE, ONDANSETRON

Primary endpoint: QoR-15swe scores preoperative (baseline) and on POD1
Endpoint(s): QoR-15swe on POD0, POD2 and POD3, Events of nausea or vomiting at PACU, at the hospital and at home up to POD3., Use of antiemetics at PACU, at the hospital and at home up to POD3., Pain assessments (NRS) at PACU, during hospital stay and at home up to POD3., Time at PACU, Time at hospital until discharge., Events of known side-effect of IMP such as infusion-site reactions, headache, visual disturbances, constipation, diarrhoea and tiredness., Complications from POD0 to POD 30 according to Clavien-Dindo, Themes from qualitative interviews of patient experiences on postoperative recovery using inductive thematic analysis (30-90 days after first visit)

Source: https://euclinicaltrials.eu/ctis-public/view/2025-522529-36-00